EU clinical trial 2024-511470-79-00: The 3TR Molecular PAthobiology and PRecision Therapy iN EaRly Rheumatoid Arthritis Study
Sponsor: Queen Mary University Of London (Educational Institution). Phase: Therapeutic use (Phase IV). Countries: Portugal (authorised, recruiting), Netherlands (ended), Italy (ongoing, recruiting), Spain (ongoing, recruiting), Belgium (ongoing, recruiting).
Therapeutic area(s): Diseases [C] - Musculoskeletal Diseases [C05]
Gender: Female, Male. Age: 18-64 years, 65+ years. Enrolment: 182.
Start date (EU): 2025-02-11. Decision date: 2025-02-11. Results received: No. Last updated: 2026-08-03.
Decision dates by country: NL: 2025-02-11, ES: 2025-02-11, PT: 2025-02-14, IT: 2025-02-12, BE: 2025-03-24

Condition(s): Rheumatoid Arthritis
Product: ORENCIA 125 mg solution for injection in pre-filled syringe, The placebo for abatacept injection for SC administration is a sterile solution product that compositionally matches the active product except for the absence of abatacept. It will be identical in dose and administration 125mg/syringe.

Primary endpoint: The primary endpoint of the study will be the delta CDAI at 16 weeks
Endpoint(s): Percentage of patients with DAS28<3.2 (LDA) at 16 weeks., Percentage of patients deemed responders using American College of Rheumatology 50 (ACR50) measure at 16 weeks., Percentage of patients with CDAI remission at 16 weeks, Change in HAQ-DI at 16 weeks from baseline., Change in SF-36 at 16 weeks from baseline

Source: https://euclinicaltrials.eu/ctis-public/view/2024-511470-79-00